EU clinical trial 2024-510735-21-00: A randomized, double-blind, placebo -controlled, multicenter trial, assessing the impact of inclisiran on major adverse cardiovascular events in participants with established cardiovascular disease (VICTORION-2 PREVENT)
Protocol code: CKJX839B12302
Sponsor: Novartis Pharma AG (Pharmaceutical company). Phase: Therapeutic confirmatory (Phase III). Countries: Romania (ongoing, recruitment ended), Croatia (ongoing, recruitment ended), Lithuania (ongoing, recruitment ended), Hungary (ongoing, recruitment ended), Sweden (ongoing, recruitment ended), Austria (ongoing, recruitment ended), Slovakia (ongoing, recruitment ended), Iceland (ongoing, recruitment ended), Estonia (ongoing, recruitment ended), Belgium (ongoing, recruitment ended), Spain (ongoing, recruitment ended), Italy (ongoing, recruitment ended), Latvia (ongoing, recruitment ended), Portugal (ongoing, recruitment ended), Slovenia (ongoing, recruitment ended), Greece (ongoing, recruitment ended), Czechia (ongoing, recruitment ended), Finland (ongoing, recruitment ended), Netherlands (ongoing, recruitment ended), Poland (ongoing, recruitment ended), France (ongoing, recruitment ended), Norway (ongoing, recruitment ended), Denmark (ongoing, recruitment ended), Bulgaria (ongoing, recruitment ended).
Therapeutic area(s): Diseases [C] - Cardiovascular Diseases [C14]
Gender: Female, Male. Age: 18-64 years, 65+ years. Enrolment: 6773.
Status: Ongoing, recruitment ended. Start date (EU): 2021-11-26. Decision date: 2024-06-27. Results received: No. Last updated: 2026-07-27.
Decision dates by country: CZ: 2024-07-02, HU: 2024-06-28, FR: 2024-07-05, IT: 2024-07-02, HR: 2024-06-28, FI: 2024-06-28, SI: 2024-07-01, SK: 2024-06-27, IS: 2024-07-15, NO: 2024-07-02, AT: 2024-07-02, LV: 2024-06-27, GR: 2024-07-22, LT: 2024-07-11, PL: 2024-07-01, BG: 2024-06-27, BE: 2024-06-28, ES: 2024-06-28, PT: 2024-06-27, RO: 2024-07-02, NL: 2024-06-28, DK: 2024-06-28, EE: 2024-07-02, SE: 2024-06-28

Condition(s): Atherosclerotic cardiovascular disease (ASCVD)
Product: ATORVASTATIN, INCLISIRAN, ATORVASTATIN, ROSUVASTATIN, ROSUVASTATIN, ROSUVASTATIN, ATORVASTATIN, ATORVASTATIN, ROSUVASTATIN, Placebo to KJX839 (Inclisiran sodium) 0 mg/1.5 mL solution for injection in pre-filled syringe

Primary endpoint: Time to first occurrence of cardiovascular death, non-fatal myocardial infarction, or non-fatal ischemic stroke (3P-MACE)
Endpoint(s): Time to cardiovascular death, Time to first occurrence of cardiovascular death, non-fatal myocardial infarction, non-fatal ischemic stroke, or urgent coronary revascularization (4P-MACE), Time to fist occurrence of Major Adverse Limb Events (MALE), Time to all-cause death, Number of participants with SAEs, Number of participants with AEs leading to study treatment discontinuation

Source: https://euclinicaltrials.eu/ctis-public/view/2024-510735-21-00